EU clinical trial 2025-521177-14-00: An open label, randomized, single-dose, two-treatment, two-period, cross-over pilot bioequivalence study comparing Pyridostigmine Bromide, P.R.Tab, 180 mg/tab, VIANEX S.A., Greece versus Mestinon® retard 180 mg/prolonged-release tablet, Viatris Healthcare GmbH, Germany, in healthy male and female volunteers under fasting conditions.
Sponsor: Vianex S.A. (Pharmaceutical company). Phase: Human Pharmacology (Phase I)- Bioequivalence Study. Countries: Czechia (ended).
Therapeutic area(s): Diseases [C] - Musculoskeletal Diseases [C05]
Gender: Female, Male. Age: 18-64 years. Enrolment: 18.
Status: Ended. Start date (EU): 2025-05-15. End date (EU): 2025-06-02. Decision date: 2025-05-07. Results received: No. Last updated: 2025-05-07.

Condition(s): treatment of myasthenia gravis

Source: https://euclinicaltrials.eu/ctis-public/view/2025-521177-14-00